EU clinical trial 2024-513482-39-00: Exploring the mechanistic link between the oxytocinergic system and mindfulness training
Sponsor: UZ Leuven (Hospital/Clinic/Other health care facility). Phase: Therapeutic exploratory (Phase II). Countries: Belgium (authorised, recruiting).
Therapeutic area(s): Psychiatry and Psychology [F] - Psychological Phenomena [F02]
Gender: Female, Male. Age: 18-64 years. Enrolment: 140.
Status: Authorised, recruiting. Start date (EU): 2025-05-15. Decision date: 2025-03-18. Results received: No. Last updated: 2026-02-05.

Condition(s): Psychological distress complaints
Product: Oxytocine CD Pharma 40 IE/ml neusspray, oplossing

Primary endpoint: self-perceived emotional stress socres using the self-report Perceived stress scale (PSS)
Endpoint(s): Assessments of the following additional self-report questionnaires: Depression Anxiety Stress Scale (DASS-21), State adult Attachment Measure (SAAM), Self-Compassion Scale-Short Form (SCS-SF), Pittsburg Sleepquality index (PSQI), Quality of life (WHO-5), Perseverative Thinking Questionnaire (PTQ), Three Facet Mindfulness Questionnaire -SF (TFMQ-SF), Profile of Mood State (POMS)

Source: https://euclinicaltrials.eu/ctis-public/view/2024-513482-39-00